EU clinical trial 2023-510441-24-00: Graft vs Host Disease Prophylaxis in unrelated donor transplantation: a randomized clinical trial comparing PTCY vs ATG
Protocol code: DKMS-21-01
Sponsor: DKMS Group gGmbH (Hospital/Clinic/Other health care facility). Phase: Therapeutic confirmatory (Phase III). Countries: Germany (ended).
Therapeutic area(s): Diseases [C] - Neoplasms [C04]
Gender: Female, Male. Age: 18-64 years, 65+ years. Enrolment: 640.
Status: Ended. Start date (EU): 2022-01-28. End date (EU): 2026-03-31. Decision date: 2024-09-20. Results received: No. Last updated: 2026-02-26.

Condition(s): Graft Vs Host Disease; Peripheral Blood Stem Cell Transplantation; AML; MDS; MDS/MPN; CMML
Product: CYCLOPHOSPHAMIDE, TACROLIMUS, Grafalon 20 mg/ml Konzentrat zur Herstellung einer Infusionslösung, MYCOPHENOLIC ACID, CYCLOPHOSPHAMIDE, CYCLOPHOSPHAMIDE

Primary endpoint: (1) overall survival (OS) from randomization, and (2) graft-versus-host disease-free and relapse-free survival (GRFS) from time of transplantation.
Endpoint(s): − Overall survival from HCT. − Relapse- and immunosuppression-free survival (RIFS) from HCT. − Event-free survival (EFS) from HCT. − Cumulative incidences of relapse from HCT. − Cumulative incidences of non-relapse mortality (NRM) from HCT, etc. (s.protocol section 10.2).

Source: https://euclinicaltrials.eu/ctis-public/view/2023-510441-24-00